EU clinical trial 2023-503787-17-00: NANOFER-THE-0504: A Trial to Assess the Safety and Tolerability of an Investigational Drug THE-0504 for Patients With Solid Tumors
Protocol code: THE-0504-001
Sponsor: Thena Biotech S.r.l. (Pharmaceutical company). Phase: Human Pharmacology (Phase I)- First administration to humans. Countries: Italy (ongoing, recruiting).
Therapeutic area(s): Diseases [C] - Neoplasms [C04]
Gender: Female, Male. Age: 18-64 years, 65+ years. Enrolment: 30.
Status: Ongoing, recruiting. Start date (EU): 2024-11-13. Decision date: 2024-09-16. Results received: No. Last updated: 2026-06-05.

Condition(s): Solid tumors

Source: https://euclinicaltrials.eu/ctis-public/view/2023-503787-17-00